EU clinical trial 2023-509334-19-00: Trial title: Phase 1b/3 global, randomized, controlled, open-label trial comparing treatment with RYZ101 to standard of care (SoC) therapy in subjects with inoperable, advanced, somatostatin receptor expressing (SSTR+), well-differentiated gastro-enteropancreatic neuroendocrine tumors (GEP-NETs) that have progressed following prior 177Lu-labelled somatostatin analogue (177Lu-SSA) therapy (ACTION-1)
Protocol code: RYZ101-301
Sponsor: Rayzebio Inc. (Pharmaceutical company). Phase: Therapeutic confirmatory (Phase III). Countries: Spain (ongoing, recruiting), France (ongoing, recruitment ended), Netherlands (ongoing, recruiting), Belgium (ongoing, recruitment ended).
Therapeutic area(s): Diseases [C] - Neoplasms [C04]
Gender: Female, Male. Age: 18-64 years. Enrolment: 78.
Start date (EU): 2024-10-17. Decision date: 2024-03-12. Results received: No. Last updated: 2026-05-21.
Decision dates by country: NL: 2024-03-12, BE: 2024-03-27, FR: 2024-03-13, ES: 2024-03-15

Condition(s): gastro-enteropancreatic neuroendocrine tumors (GEP-NETs)
Product: RYZ101, EVEROLIMUS, SUNITINIB, LANREOTIDE, OCTREOTIDE, L-ARGININE HYDROCHLORIDE, L-LYSINE HYDROCHLORIDE

Primary endpoint: Part 1: - Incidence of DLTs during the first 56 days of study treatment, Part 1: Incidence and severity of AEs by NCI CTCAE v5, including SAEs, laboratory changes, ECG changes, and other safety findings, Part 2: - PFS as determined by BICR PFS will be defined as the time from the date of randomization until the date of progression (as determined by BICR from tumor assessments using RECIST v1.1) or death due to any cause, whichever occurs first.
Endpoint(s): Part 2: - OS will be defined as the time from the date of randomization until the date of death due to any cause., ORR, as determined by BICR according to RECIST v1.1, PFS as determined by the Investigator, ORR, as assessed by the Investigator according to RECIST v1.1, BOR, disease control rate (PR + CR + SD), and DoR (only for subjects with a RECIST v1.1 response) assessed by BICR and by the Investigator according to RECIST v1.1, Incidence and severity of AEs by NCI CTCAE v5, including SAEs, laboratory changes, ECG changes, and other safety findings, PFS2 as determined by the investigator PFS2 will be defined as the time from randomization to second objective disease progression after subsequent anti-cancer therapy, or death from any cause, whichever first., Relationship between biomarkers, including but not limited to CgA in the serum and (5 HIAA) in the urine, with AEs of special interest and/or efficacy endpoints (e.g., PFS, OS, BOR, DoR), Changes in: • EQ-5D-5L • EORTC QLQ-C30 and • EORTC QLQ GI NET21 questionnaire scores, Population predicted exposure parameters (i.e. Cmax, AUC, average concentration), Relationship between exposure endpoints and clinical outcomes (efficacy and safety), PK parameters, measured by: • Cmax, Tmax, AUC, Vd, clearance, T1/2 • Percentage of radioactivity of the injected parent drug recovered in urine • ECG parameters (including QTc), measured by continuous ECG recording using a 12 lead Holter monitoring device

Source: https://euclinicaltrials.eu/ctis-public/view/2023-509334-19-00